EU clinical trial 2025-524755-31-00: Dual-agent fluorescence-guided surgery for colorectal liver metastases
Sponsor: Leids Universitair Medisch Centrum (LUMC) (Hospital/Clinic/Other health care facility). Phase: Phase II and Phase III (Integrated). Countries: Netherlands (authorised, recruitment pending).
Therapeutic area(s): Diseases [C] - Digestive System Diseases [C06]; Diseases [C] - Neoplasms [C04]
Gender: Female, Male. Age: 18-64 years, 65+ years. Enrolment: 39.
Status: Authorised, recruitment pending. Decision date: 2026-07-03. Results received: No. Last updated: 2026-07-03.

Condition(s): Colorectal liver metastases

Source: https://euclinicaltrials.eu/ctis-public/view/2025-524755-31-00